EU clinical trial 2023-507342-84-00: A Phase III Randomized, Open-Label, Multicenter Study to Determine the Efficacy and Safety of Durvalumab in Combination With Tremelimumab and Enfortumab Vedotin or Durvalumab in Combination With Enfortumab Vedotin for Perioperative Treatment in Patients Ineligible for Cisplatin or Who Refuse Cisplatin Undergoing Radical Cystectomy for Muscle Invasive Bladder Cancer (VOLGA)
Protocol code: D910PC00001 - Volga
Sponsor: Astrazeneca AB (Pharmaceutical company). Phase: Therapeutic confirmatory (Phase III). Countries: Greece (ongoing, recruitment ended), France (ongoing, recruitment ended), Spain (ongoing, recruitment ended), Portugal (ongoing, recruitment ended), Poland (ongoing, recruitment ended), Italy (ongoing, recruitment ended), Austria (ongoing, recruitment ended), Germany (ongoing, recruitment ended), Netherlands (ongoing, recruitment ended).
Therapeutic area(s): Diseases [C] - Neoplasms [C04]
Gender: Female, Male. Age: 18-64 years, 65+ years. Enrolment: 284.
Status: Ongoing, recruitment ended. Start date (EU): 2021-10-26. Decision date: 2024-07-15. Results received: No. Last updated: 2026-04-27.
Decision dates by country: GR: 2024-07-22, DE: 2024-07-19, IT: 2024-07-22, AT: 2024-07-22, PT: 2024-07-17, NL: 2024-07-17, FR: 2024-07-22, ES: 2024-07-15, PL: 2024-07-29

Condition(s): Bladder Cancer
Product: DURVALUMAB, MYCOPHENOLIC ACID, Padcev 20 mg powder for concentrate for solution for infusion, TREMELIMUMAB, Padcev 30 mg powder for concentrate for solution for infusion, INFLIXIMAB

Primary endpoint: Safety Run-In (SRI): Safety and tolerability will be evaluated in terms of AEs, vital signs, clinical laboratory assessments, ECGs, and WHO/ECOG performance status., Main Study: EFS (per BICR or by central pathology review if a biopsy is required for a suspected new lesion) is defined as the time from randomization to the first occurrence of any of the following events: - recurrence of disease post-radical cystectomy; - the first documented progression in participants who did not receive radical cystectomy; - failure to undergo radical cystectomy in participants with residual disease, or - death due to any cause
Endpoint(s): Pathologic complete response (pCR) rate is defined as the number of participants whose pathological staging was T0N0M0 as assessed per local pathology and central independent review using specimens obtained via cystectomy., Main Study: EFS (per BICR or by central pathology review if a biopsy is required for a suspected new lesion) is defined as the time from randomization to the first occurrence of any of the following events: - recurrence of disease post-radical cystectomy, - the first documented progression in participants who did not receive radical cystectomy, - failure to undergo radical cystectomy in participants with residual disease, or - death due to any cause., Main Study: OS is defined as the length of time from randomization until the date of death due to any cause., Main Study: - pCR rate as defined in the Safety Run-in; - The proportion of participants alive and event-free at 24 months (EFS24; per BICR or by central pathology review if a biopsy is required for a suspected new lesion) is defined as the Kaplan-Meier estimate of EFS at 24 months after randomization • OS5 is defined as the Kaplan-Meier estimate of OS at 5 years after randomization, Main Study: DFS (per BICR or by central pathology review if a biopsy is required for a suspected new lesion) defined as the time from the date of radical cystectomy to the first recurrence of disease post radical cystectomy, or death due to any cause, whichever occurs first in MIBC participants who undergo radical cystectomy, Main Study: pDS rate is defined as the rate of downstaging to < pT2, including pT0, pTis, pTa, pT1, and N0; - DSS is defined as the time from the date of randomization until death due to bladder cancer; - MFS is defined as the time from date of randomization until the first recognition of distant metastases or death, whichever occurs first; - pCR rate as defined above in the SRI; - EFS, OS, EFS24, OS5, DFS, pDS rate, DSS, MFS defined as secondary endpoints above., Adjusted mean change from baseline and time to definitive clinically meaningful deterioration in EORTC QLQ-C30 scale/item scores (prioritized domains: fatigue and pain, physical functioning, and global health status/QoL), Concentration of durvalumab and tremelimumab in serum and PK parameters, Presence of ADAs for durvalumab and tremelimumab, Safety and tolerability will be evaluated in terms of AEs, vital signs, clinical laboratory assessments, ECGs, and WHO/ECOG performance status, as described for the corresponding safety run-in objectives and endpoints

Source: https://euclinicaltrials.eu/ctis-public/view/2023-507342-84-00